EU clinical trial 2025-524784-20-00: A Phase 2a, Open-Label Pilot Study to Evaluate the Safety/Tolerability, Efficacy, Pharmacokinetics, and Pharmacodynamics of VTX2735 in Participants with Recurrent Pericarditis
Protocol code: VTX2735-202
Sponsor: Zomagen Biosciences Limited (Pharmaceutical company). Phase: Therapeutic exploratory (Phase II). Countries: Belgium (authorised, recruitment pending).
Therapeutic area(s): Diseases [C] - Cardiovascular Diseases [C14]
Gender: Female, Male. Age: 65+ years. Enrolment: 10.
Status: Authorised, recruitment pending. Decision date: 2026-02-27. Results received: No. Last updated: 2026-06-30.

Condition(s): Recurrent Pericarditis

Primary endpoint: Incidence and severity of AEs, SAEs, and AEs leading to study treatment discontinuation from the first dose through end of the Follow-Up Period.
Endpoint(s): Change from baseline in NRS over time through Week 6; Percent change from baseline in NRS over time through Week 6, Change from baseline in hs-CRP over time through Week 6 ; Percent change from baseline in hs-CRP over time through Week 6; Change from baseline in hs-CRP over time through Week 6 in participants with baseline CRP > 10 mg/L ; Percent change from baseline in hs-CRP over time through Week 6 in participants with baseline CRP > 10 mg/L

Source: https://euclinicaltrials.eu/ctis-public/view/2025-524784-20-00